EU clinical trial 2024-515034-33-00: A Phase I/II Open-Label Multi-Centre Master Protocol to Evaluate the Safety and Efficacy of AZD0486 Monotherapy or in Combination with Other Anticancer Agents in Participants with Mature B-Cell Malignancies Substudy 1: Chronic Lymphocytic Leukaemia and Small Lymphocytic Lymphoma; Substudy 2: Mantle Cell Lymphoma; Substudy 3: Large B-Cell Lymphoma
Protocol code: D7407C00001
Sponsor: AstraZeneca AB (Pharmaceutical company). Phase: Phase I and Phase II (Integrated)- Other. Countries: Denmark (ongoing, recruiting), France (ongoing, recruiting), Spain (ongoing, recruiting), Germany (ongoing, recruiting), Czechia (ongoing, recruiting).
Therapeutic area(s): Diseases [C] - Neoplasms [C04]
Gender: Female, Male. Age: 18-64 years, 65+ years. Enrolment: 200.
Status: Ongoing, recruiting. Start date (EU): 2025-03-05. Decision date: 2025-01-07. Results received: No. Last updated: 2026-06-05.
Decision dates by country: DK: 2025-01-09, FR: 2025-01-10, DE: 2025-01-09, ES: 2025-01-07, CZ: 2025-01-08

Condition(s): Chronic Lymphocytic Leukaemia, Large B-Cell Lymphoma, Mantle Cell Lymphoma, Small Lymphocytic Lymphoma
Product: Calquence 100 mg film-coated tablets, AZD0486, RITUXIMAB, AZD0486, AZD0486, CYCLOPHOSPHAMIDE, PREDNISONE, RITUXIMAB, PREDNISOLONE, VINCRISTINE, DOXORUBICIN, Calquence 100 mg film-coated tablets, AZD0486

Primary endpoint: Incidence, nature and severity of AEs/SAEs based on NCI CTCAE v5.0/ASTCT criteria; changes in laboratory data, and vital signs compared with baseline, Incidence of Dose Limiting Toxicity (DLTs), Incidence and severity of AESIs, Incidence and nature of study drug discontinuation, dose reduction and dose delay due to AEs

Source: https://euclinicaltrials.eu/ctis-public/view/2024-515034-33-00